EU clinical trial 2025-522914-22-00: A Study of JNJ-90301900 in Combination with Concurrent Chemoradiation Therapy in LA HNSCC
Protocol code: 90301900HNC1001
Sponsor: Janssen Cilag International (Pharmaceutical company). Phase: Human Pharmacology (Phase I)- Other. Countries: France (ongoing, recruiting).
Therapeutic area(s): Diseases [C] - Neoplasms [C04]
Gender: Female, Male. Age: 18-64 years, 65+ years. Enrolment: 8.
Status: Ongoing, recruiting. Start date (EU): 2026-02-11. Decision date: 2026-02-02. Results received: No. Last updated: 2026-07-27.

Condition(s): Locally Advanced Head and Neck Squamous Cell Carcinoma (LA HNSCC)

Source: https://euclinicaltrials.eu/ctis-public/view/2025-522914-22-00